EU clinical trial 2023-510508-31-01: Longitudinal multicenter head-to-head harmonization of tau PET tracers (HEAD Study)
Protocol code: IIBSP-HEA-2022-145
Sponsor: Fundacio Institut De Recerca De L Hospital De La Santa Creu I Sant Pau (Hospital/Clinic/Other health care facility). Phase: Therapeutic exploratory (Phase II). Countries: Spain (ongoing, recruiting).
Therapeutic area(s): Analytical, Diagnostic and Therapeutic Techniques and Equipment [E] - Diagnosis [E01]; Diseases [C] - Nervous System Diseases [C10]
Gender: Female, Male. Age: 18-64 years. Enrolment: 150.
Status: Ongoing, recruiting. Start date (EU): 2024-07-01. Decision date: 2024-06-19. Results received: No. Last updated: 2024-12-03.

Condition(s): cognitive impairment
Product: florquinitau F-18, VIZAMYL 400 MBq/mL solution for injection, [18F]PI-2620

Primary endpoint: The main outcome variable derived from the administration of the radiopharmaceutical will be the Standardized Uptake Value Ratio (SUVR) from different PET tau images, which will be co-registered with the structural MRI image. The lower cerebellar cortex will be used as a reference region
Endpoint(s): SUVR values obtained for different tracers., Voxel-wise and regional correlation analysis., Transformed values to standardize tau PET tracers to a common scale., Diagnostic performance among different groups., Associations of tau tracers with amyloid., Associations of tau tracers with brain atrophy., Associations of tau tracers with cognition., Associations of tau tracers with plasma tau biomarkers (p-tau181, p-tau-217, and p-tau231)., Longitudinal tau accumulation rates among tracers., Associations between longitudinal changes in tau and amyloid deposition., Associations between longitudinal changes in tau and brain atrophy., Asociaciones entre los cambios longitudinales en tau y progresión en cognición.

Source: https://euclinicaltrials.eu/ctis-public/view/2023-510508-31-01